EU clinical trial 2024-516205-23-00: Image-guided de-escalation of neoadjuvant chemotherapy in HER2-positive breast cancer: the TRAIN-3 study
Protocol code: BOOG 2018-01
Sponsor: BOOG Study Center B.V. (Laboratory/Research/Testing facility). Phase: Therapeutic exploratory (Phase II). Countries: Netherlands (ongoing, recruitment ended).
Therapeutic area(s): Diseases [C] - Neoplasms [C04]
Gender: Female, Male. Age: 18-64 years, 65+ years. Enrolment: 472.
Status: Ongoing, recruitment ended. Start date (EU): 2019-04-09. Decision date: 2024-11-12. Results received: No. Last updated: 2024-11-12.

Condition(s): Breast cancer
Product: Herceptin 150 mg powder for concentrate for solution for infusion, Kadcyla 160 mg powder for concentrate for solution for infusion., Herceptin 600 mg solution for injection in vial, Kadcyla 100 mg powder for concentrate for solution for infusion., PACLITAXEL, CARBOPLATIN, Perjeta 420 mg concentrate for solution for infusion

Primary endpoint: Three-year event-free survival
Endpoint(s): Overall survival (OS), defined as the time from registration to death from any cause., Pathologic complete response in breast and axilla, defined as the absence of invasive tumor cells, irrespective of the presence of in-situ lesions, Radiologic complete response, defined as the absence of pathologic enhancement on MRI and normalization of possible lymph node involvement at ultrasound and FNA examination, Concordance between radiologic response and pathologic response: difference in EFS and OS between patient with rCR after 3, 6, and 9 cycles, Difference in EFS and OS between patient with pCR after 3, 6, and 9 cycles, Difference in radical resections in rCR and no‐rCR, Health‐related quality of life

Source: https://euclinicaltrials.eu/ctis-public/view/2024-516205-23-00